EU clinical trial 2025-522544-40-00: TRITON-PN: A Phase 3, Global, Randomized, Open-Label Study to Evaluate the Efficacy and Safety of Nucresiran in Patients with Hereditary Transthyretin-Mediated Amyloidosis with Polyneuropathy (hATTR-PN)
Protocol code: ALN-TTRSC04-004
Sponsor: Alnylam Pharmaceuticals Inc. (Pharmaceutical company). Phase: Therapeutic confirmatory (Phase III). Countries: France (ongoing, recruiting), Italy (ongoing, recruiting), Greece (ongoing, recruiting), Spain (ongoing, recruiting), Sweden (ongoing, recruiting), Ireland (authorised, recruitment pending), Cyprus (ongoing, recruiting), Portugal (ongoing, recruiting), Germany (ongoing, recruiting).
Therapeutic area(s): Diseases [C] - Nervous System Diseases [C10]; Diseases [C] - Congenital, Hereditary, and Neonatal Diseases and Abnormalities [C16]
Gender: Female, Male. Age: 18-64 years, 65+ years. Enrolment: 86.
Start date (EU): 2026-03-27. Decision date: 2026-02-20. Results received: No. Last updated: 2026-07-29.
Decision dates by country: FR: 2026-02-25, GR: 2026-02-24, IE: 2026-02-27, IT: 2026-02-25, ES: 2026-02-27, SE: 2026-02-20, CY: 2026-03-06, DE: 2026-02-24, PT: 2026-02-25

Condition(s): Hereditary transthyretin-mediated amyloidosis with polyneuropathy
Product: Amvuttra 25 mg solution for injection in pre-filled syringe, ALN-TTRSC04

Primary endpoint: Change from baseline in the Modified Neuropathy Impairment Score +7 (mNIS+7) compared to the external placebo group from the APOLLO study at Month 9
Endpoint(s): 1. Change from baseline in Norfolk Quality of Life Diabetic Neuropathy (Norfolk QoL-DN) total score compared to the external placebo group from the APOLLO study at Month 9, 2. Percent reduction in serum TTR levels in the nucresiran group compared to the in-study vutrisiran group through Month 9, 3. Change from baseline in modified body mass index (mBMI) compared to the external placebo group from the APOLLO study at Month 9, 4. Change from baseline in the following parameters compared to the external placebo group from the APOLLO study at Month 18: o mNIS+7; o Norfolk QoL-DN total score; o mBMI; o Rasch-built Overall Disability Scale R-ODS; o Timed 10-meter walk test (10-MWT), 5. Percent reduction in serum TTR levels in the nucresiran group compared to the in-study vutrisiran group through Month 18, 6. Percent reduction in serum TTR levels in the nucresiran group compared to the in-study vutrisiran group at Week 6

Source: https://euclinicaltrials.eu/ctis-public/view/2025-522544-40-00